EU clinical trial 2022-501251-81-00: A Phase 3, Randomized, Double-Blind, Placebo-Controlled Clinical Trial of Pembrolizumab (MK-3475) as Monotherapy in the Adjuvant Treatment of Renal Cell Carcinoma Post Nephrectomy (KEYNOTE-564)
Protocol code: MK-3475-564
Sponsor: Merck Sharp & Dohme LLC (Pharmaceutical company). Phase: Therapeutic confirmatory (Phase III). Countries: Netherlands (ended), Poland (ended), Finland (ended), Spain (ended), Czechia (ended), Ireland (ended), Italy (ended), France (ended), Germany (ended).
Therapeutic area(s): Diseases [C] - Neoplasms [C04]
Gender: Female, Male. Age: 18-64 years, 65+ years. Enrolment: 350.
Status: Ended. Start date (EU): 2017-06-08. End date (EU): 2026-01-28. End date: 2026-02-04. Decision date: 2023-01-18. Results received: No. Last updated: 2026-02-02.
Decision dates by country: PL: 2023-01-23, FI: 2023-01-20, IE: 2023-01-18, FR: 2023-01-26, CZ: 2023-01-23, IT: 2023-01-23, NL: 2023-01-19, ES: 2023-01-23, DE: 2023-01-19

Condition(s): Renal cell carcinoma
Product: KEYTRUDA 25 mg/mL concentrate for solution for infusion, Sodium Chloride Intravenous Infusion BP 0.9% w/v

Primary endpoint: Disease-free Survival (DFS) as Assessed by the Investigator
Endpoint(s): Overall Survival (OS), Number of Participants Who Experienced an Adverse Event (AE), Number of Participants Who Discontinued Study Drug Due to an AE, First Local Disease Recurrence-specific Survival (DRSS1) as Assessed by the Investigator, Visceral Disease Recurrence-Specific Survival (DRSS2) as Assessed by the Investigator, Event-Free Survival (EFS) as Assessed by the Blinded Independent Central Review (BICR), DFS According to Participant Programmed Cell Death-Ligand 1 (PD-L1) Expression Status (Positive, Negative) as Assessed by the Investigator, OS According to Participant PD-L1 Expression Status (Positive, Negative), Change From Baseline in the European Organization for the Research and Treatment of Cancer Quality of Life Questionnaire C30 (EORTC QLQ-C30) Total Score, Change From Baseline in the Functional Assessment of Cancer Therapy Kidney Symptom Index-Disease Related Symptoms (FKSI-DRS) Index Score

Source: https://euclinicaltrials.eu/ctis-public/view/2022-501251-81-00